EU clinical trial 2024-520351-24-00: Prasugrel Monotherapy Reduced dose in Acute and Chronic Coronary Syndrome Patients after Percutaneous Coronary Intervention
Sponsor: Amsterdam UMC Stichting (Patient organisation/association). Phase: Therapeutic use (Phase IV). Countries: Netherlands (ongoing, recruitment ended).
Therapeutic area(s): Diseases [C] - Cardiovascular Diseases [C14]
Gender: Female, Male. Age: 18-64 years, 65+ years. Enrolment: 300.
Status: Ongoing, recruitment ended. Start date (EU): 2025-11-13. Decision date: 2025-07-18. Results received: No. Last updated: 2025-10-09.

Condition(s): Acute coronary syndrome and chronic coronary syndrome
Product: Efient 5 mg film-coated tablets.

Primary endpoint: Net Adverse Clinical Events (NACE), a composite of all-cause mortality, myocardial infarction, definite stent thrombosis, ischemic stroke, major bleeding or clinically relevant non-major bleeding defined as BARC type 2, 3 or 5
Endpoint(s): Treatment satisfaction, based on the Treatment Satisfaction Questionnaire for Medication II (TSQM-II), Treatment adherence, based on the Morisky Medication Adherence Scale (MMAS-8), Each individual component of the primary endpoint, Cardiovascular mortality, Non-cardiovascular mortality, Any need for revascularization, Major or clinically relevant non-major bleeding defined as BARC type 2, 3 or 5, Minor or clinically relevant non-major bleeding defined as BARC type 2 at 1, 6 and 12 month(s), Any periprocedural complications, On-treatment platelet reactivity at week 2 in the first 40 patients, Non-adherence to antiplatelet regimen

Source: https://euclinicaltrials.eu/ctis-public/view/2024-520351-24-00